EU clinical trial 2025-521155-23-00: C5001004 - A Phase 2, Open-Label Extension Study to Investigate the Safety and Efficacy of PF-07868489 Administered to Adult Participants With Pulmonary Arterial Hypertension
Protocol code: C5001004
Sponsor: Pfizer Inc. (Pharmaceutical company). Phase: Therapeutic exploratory (Phase II). Countries: Italy (authorised, recruiting), Czechia (ongoing, recruitment ended), Germany (ongoing, recruitment ended), Greece (authorised, recruiting), Spain (ongoing, recruitment ended), Belgium (ongoing, recruitment ended), France (authorised, recruiting).
Therapeutic area(s): Diseases [C] - Cardiovascular Diseases [C14]
Gender: Female, Male. Age: 18-64 years, 65+ years. Enrolment: 10.
Start date (EU): 2025-12-19. Decision date: 2025-12-02. Results received: No. Last updated: 2026-06-10.
Decision dates by country: ES: 2025-12-11, BE: 2025-12-18, CZ: 2025-12-02, FR: 2025-12-19, IT: 2025-12-05, GR: 2025-12-22, DE: 2025-12-05

Condition(s): Pulmonary Arterial Hypertension
Product: PF-07868489

Primary endpoint: Incidence and severity of treatment emergent Adverse Events (AEs) and Serious Adverse Events (SAEs)., Incidence of related treatment emergent AEs (TEAEs) & treatment emergent SAEs (TESAEs)., Change from baseline in vital signs., Change from baseline in clinical laboratory values., Change from baseline in electrocardiogram (ECG) parameters (heart rate, QT, QTc corrected using Fridericia’s formula (QTcF), PR, and QRS intervals).
Endpoint(s): Change from baseline in NT-pro-BNP., PF-07868489 PK parameters after repeat doses; as data permit: minimum plasma concentration (Cmin)., Incidence of the development of antidrug antibody (ADA) against PF-07868489 following repeat doses.

Source: https://euclinicaltrials.eu/ctis-public/view/2025-521155-23-00